EU clinical trial 2024-519789-37-00: Rezafungin plasma concentrations in patients with or without extracorporal treatments (ECMO ± RRT)
Sponsor: Medical University Of Graz (Educational Institution). Phase: Phase III and phase IV (Integrated). Countries: Austria (ongoing, recruiting).
Therapeutic area(s): Diseases [C] - Bacterial Infections and Mycoses [C01]
Gender: Female, Male. Age: 18-64 years, 65+ years. Enrolment: 30.
Status: Ongoing, recruiting. Start date (EU): 2025-04-16. Decision date: 2025-04-14. Results received: No. Last updated: 2026-01-26.

Condition(s): Invasive candidiasis
Product: REZZAYO 200 mg powder for concentrate for solution for infusion

Primary endpoint: Clearance (CL), Volume of Distribution (Vd), Half-Life (t½), Absorption Rate Constant (Ka), Bioavailability (F), Maximum Concentration (Cmax), Time to Maximum Concentration (Tmax), Area Under the Curve (AUC), Elimination Rate Constant (Ke)
Endpoint(s): Difference in Rezafunding plasma concentration according to additional extracorporal circuits (RRT, Hemoperfusion), Difference of Rezafunding plasma concentration according to body-mass index and gender, Side effects of Rezafungin treatment (As defined by the treating physician), Rate of Rezafungin discontinuation and reasons for cessation

Source: https://euclinicaltrials.eu/ctis-public/view/2024-519789-37-00